EU clinical trial 2023-507202-14-00: An Integrated Phase I/II, Multicentre, Double-Blind, Randomised, Dysport and Placebo Controlled, Dose-Escalation and Dose-Finding Study to Evaluate the Safety and Efficacy of IPN10200 in the treatment of Adult Upper Limb Spasticity Followed by an Open-label Extension Period
Protocol code: D-FR-10200-001
Sponsor: Ipsen Innovation (Pharmaceutical company). Phase: Phase I and Phase II (Integrated)- First administration to humans. Countries: Bulgaria (ongoing, recruiting), Poland (ongoing, recruiting), Austria (ongoing, recruiting), Czechia (ongoing, recruiting), Germany (ongoing, recruiting), Spain (ongoing, recruiting), Hungary (ongoing, recruiting), Italy (ongoing, recruiting), Portugal (ongoing, recruiting), France (ended).
Therapeutic area(s): Diseases [C] - Nervous System Diseases [C10]
Gender: Female, Male. Age: 18-64 years, 65+ years. Enrolment: 296.
Start date (EU): 2021-04-29. Decision date: 2024-05-28. Results received: No. Last updated: 2026-08-06.
Decision dates by country: AT: 2024-05-31, BG: 2024-05-31, CZ: 2024-06-03, DE: 2024-05-29, HU: 2024-06-04, ES: 2024-05-28, PL: 2024-06-10, IT: 2025-12-18, PT: 2026-01-12, FR: 2025-12-23

Condition(s): Upper limb spasticity after stroke or traumatic brain injury
Product: IPN10200 placebo, Powder for solution for injection, DYSPORT 500 UNITES SPEYWOOD, poudre pour solution injectable

Primary endpoint: Percentage of participants with treatment emergent adverse events (TEAEs)., Percentage of participants with adverse events of special interest (AESI)., Change from baseline in vital sign parameter (blood pressure), Change from baseline in vital sign parameter (Heart rate), Change from baseline in clinical laboratory test results., Presence of IPN10200 and BoNT-A antibodies (binding and neutralising), Change from baseline in physical examination findings, Response to treatment measured by at least one grade reduction in Modified Ashworth Scale (MAS) score in the primary targeted muscle group (PTMG).
Endpoint(s): Change from Baseline to all post-treatment visits in Modified Ashworth scale (MAS) score in the Primary target muscle group (PTMG), Change from Baseline to post-treatment Day 29 in MAS score in the PTMG, Change from Baseline in MAS score in all injected muscle Groups, PD characteristics of IPN10200 in the PTMG: o Time to onset - time to the response to treatment (a reduction of at least one grade in the MAS score). o Peak of effect - maximal decrease in the MAS score from Baseline. o Time to peak - time to reach the peak of effect (maximal decrease in the MAS score from Baseline). o Duration of effect - duration between time to onset and last timepoint with a response to Treatment, Response to treatment as measured by at least one grade reduction in MAS score in the PTMG from Baseline, Response to treatment as measured by at least one grade reduction in MAS score in all injected muscle groups, Physician’s Global Assessment (PGA) score of overall treatment response, Patient Global Impression of Change in the Spastic Clinical Pattern using specific scale (PGI-c), Change from Baseline in the Disability Assessment Scale (DAS), Reduction of pain in the shoulder using the Numeric Rating Scale, Change from Baseline in the Tardieu Scale (TS) in the PTMG, Change from Baseline in the active range of motion (AROM) in all injected muscle groups including the PTMG, Percentage of participants with TEAEs., Percentage of participants with AESIs., Percentage of participants with clinically significant changes from baseline in vital signs, Percentage of participants with clinically significant change from baseline in 12-lead Electrocardiogram (ECG) readings, Percentage of Participants with clinically significant changes from baseline in Laboratory Parameters, Percentage of participants with Binding antibodies of IPN10200 and BoNT-A, Percentage of participants with neutralising antibodies of IPN10200 and BoNT-A, Percentage of participants with clinically significant change from baseline in physical examination, Change from Baseline in MAS score in the PTMG., Change from Baseline in MAS score in all injected muscle groups., Response to treatment as measured by at least one grade reduction in MAS score in the PTMG, Response to treatment as measured by at least one grade reduction in MAS score in all injected muscle groups, Time to onset - time to the response to treatment (a reduction of at least one grade in the MAS score)., Peak of effect - maximal decrease in the MAS score from Baseline., Time to peak - time to reach the peak of effect (maximal decrease in the MAS score from Baseline)., Duration of effect - duration between time to onset and last timepoint with a response to treatment., PGA score of overall treatment response at all post treatment visits, PGIC at all post-treatment visits., Change from Baseline to all post-treatment visits in the DAS., Change from baseline to all post-treatment visits in NRS pain in the shoulder., Change from Baseline in the Tardieu Scale in shoulder adductors, Change from Baseline in the Tardieu Scale in elbow flexors, Change from Baseline in the Tardieu Scale in wrist flexors (when applicable), Change from Baseline in the Tardieu Scale in finger flexors (when applicable) at all timepoints, Change from Baseline to all post-treatment visits in AROM in all injected muscle groups.

Source: https://euclinicaltrials.eu/ctis-public/view/2023-507202-14-00